EU clinical trial 2025-523231-19-00: A Phase 2 study of intratumoral administration of L19IL2/L19TNF in locally advanced Cutaneous Squamous Cell Carcinoma patients progressing on or intolerant to systemic treatment.
Sponsor: Philogen S.p.A. (Pharmaceutical company). Phase: Therapeutic exploratory (Phase II). Countries: Italy (authorised, recruiting), Germany (authorised, recruiting), Greece (authorised, recruitment pending), Spain (authorised, recruiting).
Therapeutic area(s): Diseases [C] - Skin and Connective Tissue Diseases [C17]; Diseases [C] - Neoplasms [C04]
Gender: Female, Male. Age: 18-64 years, 65+ years. Enrolment: 54.
Start date (EU): 2026-04-27. Decision date: 2026-02-10. Results received: No. Last updated: 2026-08-05.
Decision dates by country: GR: 2026-02-11, ES: 2026-02-16, IT: 2026-02-10, DE: 2026-02-11

Condition(s): Cutaneous Squamous Cell Carcinoma
Product: Fibromun, Darleukin

Primary endpoint: Best Overall Response Rate (BORR) as defined by the RECIST 1.1. criteria according to an Independent Central Review (ICR).

Source: https://euclinicaltrials.eu/ctis-public/view/2025-523231-19-00